EU clinical trial 2023-507365-26-00: Combination of pembrolizumab with oral metronomic cyclophosphamide in patients with chest wall breast cancer (PERICLES): A phase II study
Sponsor: Istituto Europeo Di Oncologia S.r.l. (Hospital/Clinic/Other health care facility). Phase: Therapeutic exploratory (Phase II). Countries: Italy (ended).
Therapeutic area(s): Diseases [C] - Neoplasms [C04]
Gender: Female, Male. Age: 18-64 years, 65+ years. Enrolment: 46.
Status: Ended. Start date (EU): 2020-05-20. End date (EU): 2025-12-03. Decision date: 2024-07-29. Results received: No. Last updated: 2024-12-10.

Condition(s): Locally recurrent, inoperable, and/or metastatic inflammatory breast cancer with lymphangitic spread to the chest wall
Product: KEYTRUDA 25 mg/mL concentrate for solution for infusion, Endoxan Baxter 50 mg Compresse rivestite

Primary endpoint: Primary endpoint will be objective response (confirmed CR or PR as best overall response) based on irRECIST criteria and also based on evaluable disease.
Endpoint(s): Progression free survival, Duration of response, Overall survival

Source: https://euclinicaltrials.eu/ctis-public/view/2023-507365-26-00